EU clinical trial 2022-500319-38-00: The NODE-202 Study Multi-Center, Multi-National, Open-Label, Efficacy and Safety Study of Etripamil Nasal Spray in Pediatric Patients with Paroxysmal Supraventricular Tachycardia
Protocol code: MSP-2017-1265
Sponsor: Milestone Pharmaceuticals Inc. (Pharmaceutical company). Phase: Therapeutic exploratory (Phase II). Countries: Netherlands (authorised, recruitment pending), Germany (authorised, recruiting), Spain (ongoing, recruiting).
Therapeutic area(s): Diseases [C] - Cardiovascular Diseases [C14]
Gender: Female, Male. Age: 0-17 years. Enrolment: 30.
Start date (EU): 2024-05-03. Decision date: 2023-08-21. Results received: No. Last updated: 2026-07-03.
Decision dates by country: ES: 2023-08-28, NL: 2023-08-21, DE: 2023-08-23

Condition(s): Paroxysmal supraventricular tachycardia (PSVT)
Product: Etripamil

Primary endpoint: Efficacy: The percentage of patients converting to SR in the first 15 minutes after administration of etripamil NS. A successful conversion is defined as conversion of PSVT to SR that is maintained for at least 30 seconds.
Endpoint(s): Time to termination of the PSVT episode and conversion to sinus rhythm (SR), Percentage of patients requiring additional medical intervention treatment for the PSVT episode in the first 15 minutes after study drug administration, Frequency of AEs, Local (administration site) tolerability, Post-dose changes in vital signs (HR and BP)

Source: https://euclinicaltrials.eu/ctis-public/view/2022-500319-38-00